EU clinical trial 2024-513304-33-00: A Phase III, Randomized, Double-blind, Placebo-controlled, Multicenter Trial to Evaluate the Efficacy and Safety of Diamyd® to Preserve Endogenous Beta Cell Function in Adolescents and Adults with Recently Diagnosed Type 1 Diabetes, Carrying the Genetic HLA DR3-DQ2 Haplotype
Protocol code: DIAGNODE-3
Sponsor: Diamyd Medical AB (Pharmaceutical company). Phase: Therapeutic confirmatory (Phase III). Countries: Germany (ended), Spain (ended), Czechia (ended), Netherlands (ended), Hungary (ended), Estonia (ended), Sweden (ended), Poland (ended).
Therapeutic area(s): Phenomena and Processes [G] - Metabolism [G03]
Gender: Female, Male. Age: 0-17 years, 18-64 years. Enrolment: 280.
Status: Ended. Start date (EU): 2022-03-17. End date (EU): 2026-04-10. End date: 2026-06-24. Decision date: 2024-07-11. Results received: No. Last updated: 2026-04-07.
Decision dates by country: DE: 2024-07-16, HU: 2024-07-15, EE: 2024-07-16, PL: 2024-07-26, SE: 2024-07-12, ES: 2024-07-12, CZ: 2024-07-16, NL: 2024-07-11

Condition(s): Type 1 diabetes mellitus
Product: Divisun 2000 IE tabletter, Alhydrogel®, Diamyd

Primary endpoint: Change from baseline to Month 15 in C-peptide AUC mean 0-120 min during a 2-hour MMTT, Change from baseline to Month 15 in HbA1c
Endpoint(s): Change in time in glycemic target range 3.9 to 10 mmol/L (70 to 180 mg/dL) [evaluated from continuous glucose monitoring (CGM) data] between baseline and Month 15, Number of episodes per patient of severe hypoglycemia between baseline and Month 15, Number of episodes per patient of DKA between baseline and Month 15, Incidence of treatment-emergent adverse events (TEAEs), Incidence of injection site reactions, Physical examination findings, Vital signs (blood pressure [BP], heart rate [HR], and temperature), Clinical laboratory results (chemistry, hematology, and urine), Proportion of patients with a stimulated 90 min C-peptide level above 0.2 nmol/L (0.6 ng/ml) at Month 15, Proportion of patients with HbA1c <7 % (53 mmol/ mol) at Month 15, Change from baseline to Month 15 in exogenous insulin requirements based on total number of units of insulin per kilogram body weight per day, Change in number of hypoglycemic <3.0 mmol/L (<54 mg/dL) episodes per day [evaluated from CGM data] between baseline and Month 15, Area Under the Curve for Change from Baseline to Month 15 in HbA1c., Change from baseline to Month 24 in C peptide area under the curve (AUC)mean 0-120 min during a 2 hour mixed meal tolerance test (MMTT), Change from baseline to Month 24 in hemoglobin A1c (HbA1c).

Source: https://euclinicaltrials.eu/ctis-public/view/2024-513304-33-00